EU clinical trial 2023-504282-23-00: European, multicentre, single arm (phase I) trial of autologous skeletal muscle derived cell (ASMDC) microcarrier combination for the treatment of faecal incontinence (FI) in women with obstetric anal sphincter injury.
Protocol code: AMELIE
Sponsor: University College London (Educational Institution). Phase: Human Pharmacology (Phase I)- First administration to humans. Countries: France (ended), Spain (ended), Austria (ended), Denmark (ended).
Therapeutic area(s): Diseases [C] - Female Urogenital Diseases and Pregnancy Complications [C13]
Gender: Female. Age: 18-64 years, 65+ years. Enrolment: 8.
Status: Ended. End date (EU): 2026-05-08. Decision date: 2025-10-28. Results received: No. Last updated: 2026-01-06.
Decision dates by country: AT: 2025-11-03, FR: 2025-10-29, ES: 2025-11-03, DK: 2025-10-28

Condition(s): Faecal incontinence

Source: https://euclinicaltrials.eu/ctis-public/view/2023-504282-23-00